EU clinical trial 2024-520166-63-00: Hysteroscopic resection versus medical management of early pregnancy loss (HyME): a randomized controlled trial
Sponsor: UZ Brussel (Hospital/Clinic/Other health care facility). Phase: Phase III and phase IV (Integrated). Countries: Belgium (ongoing, recruiting).
Therapeutic area(s): Diseases [C] - Female Urogenital Diseases and Pregnancy Complications [C13]
Gender: Female. Age: 18-64 years. Enrolment: 152.
Status: Ongoing, recruiting. Start date (EU): 2025-12-18. Decision date: 2025-11-26. Results received: No. Last updated: 2025-11-26.

Condition(s): Early pregnancy loss (< 10 weeks of gestation)
Product: Mifegyne 200 mg comprimés - FR, Mifegyne 200 mg Tabletten - DE, CYTOTEC 200 microgrammes, comprimés., Mifegyne 200 mg tabletten - NL, CYTOTEC 200 microgram tabletten., Cytotec 200 Mikrogramm Tabletten

Primary endpoint: Complete trophoblastic tissue expulsion, measured by the presence of a retained product of conception (RPOC) at ultrasound and diagnostic hysteroscopy ~1-2 month following intervention and the need for a secondary hysteroscopic resection
Endpoint(s): Intra-uterine adhesion rates at diagnostic hysteroscopy 1-2 months following complete evacuation, Pregnancy rates in the year following randomization, Rate of successful genetic analysis on the product of conception, Time needed to conceive, Complications occurring until 30 days post treatment, Patient well-being and quality of life evaluated by questionnaires 1-month and 3-months after the procedure

Source: https://euclinicaltrials.eu/ctis-public/view/2024-520166-63-00